EU clinical trial 2024-516293-29-01: An Open-Label, Multicenter, Extension Study for Subjects Who Participated in Prior Clinical Studies of ASTX727
Protocol code: ASTX727-06
Sponsor: Taiho Oncology Inc. (Pharmaceutical company). Phase: Therapeutic exploratory (Phase II). Countries: Romania (ongoing, recruiting), Bulgaria (ongoing, recruiting), Hungary (ongoing, recruiting), Poland (authorised, recruitment pending), Austria (ongoing, recruiting), Germany (ended), Spain (ongoing, recruiting), Slovakia (authorised, recruiting).
Therapeutic area(s): Diseases [C] - Neoplasms [C04]
Gender: Female, Male. Age: 18-64 years, 65+ years. Enrolment: 100.
Start date (EU): 2022-03-17. Decision date: 2024-10-04. Results received: No. Last updated: 2026-03-12.
Decision dates by country: DE: 2024-10-11, SK: 2024-10-04, PL: 2024-11-13, AT: 2024-11-05, HU: 2024-10-04, BG: 2024-10-04, RO: 2024-10-15, ES: 2024-10-15

Condition(s): Acute myeloid lymphoma (AML), myelodysplastic syndrome (MDS), chronic myelomonocytic leukemia (CMML) or solid tumors
Product: ASTX727

Primary endpoint: Safety as measured by AEs

Source: https://euclinicaltrials.eu/ctis-public/view/2024-516293-29-01